EU clinical trial 2026-526383-20-00: B-HAPPI: Bipolar disorder and high-dose adjunctive pramipexole for anhedonic depression – a phase III, double-blind, randomized controlled trial
Sponsor: Region Skane (Hospital/Clinic/Other health care facility). Phase: Therapeutic confirmatory (Phase III). Countries: Sweden (authorised, recruitment pending).
Therapeutic area(s): Psychiatry and Psychology [F] - Mental Disorders [F03]
Gender: Female, Male. Age: 18-64 years, 65+ years. Enrolment: 186.
Status: Authorised, recruitment pending. Decision date: 2026-07-29. Results received: No. Last updated: 2026-07-29.

Condition(s): Bipolar disorder
Product: Pramipexol AL 0.26 mg Retardtabletten, Pramipexol AL 0,52 mg Retardtabletten, Placebo tablets for oral administration matching the commercially available 0.26 mg, 0.52 mg, 1.05 mg, and 2.10 mg of base Pramipexole AL oral tablets, Pramipexol AL 1,05 mg Retardtabletten, Pramipexol AL 2,1 mg Retardtabletten

Primary endpoint: Change in SHAPS self-rating scale between baseline and week 6
Endpoint(s): Change in MADRS expert rating scale between baseline and week 6, Accelerometery data analysing 24-hour movement behaviour, including physical activity. Change in Sedentary Behaviour (SED), Low-Intensity Physical Activity (LPA) and Moderate- to Vigorous Physical Activity (MVPA), between baseline and every post-baseline visit., Change in DARS and AES scores between baseline and week 6, Change in CGI-S and EQ-5D-5L between baseline and week 6, Systematic registration of AEs and SAEs, with focus on (hypo)manic symptoms (YMRS) and impulse control related symptoms using relevant items from the M-QUIP-RS and M-PGSI. We will also assess alcohol and substance abuse using the Alcohol/Drug Use Disorders Identification Tests (AUDIT/DUDIT) at baseline, week 6 and week 15., Extension phase, open-label follow-up study for up to 15 weeks after RCT phase, including the same rating scales, clinical and safety assessments as in the RCT phase., Clinical improvement per structured clinical assessments (e.g. Association for Methodology and Documentation in Psychiatry), Digital neuropsychological test battery comprising the Trail Making Test, Rey Auditory Verbal Learning Test, Click Reaction Time, Victoria Stroop Test, Digital Corsi Block-Tapping Test, Symbol Digit Processing Test, and the Verbal Fluency Test, BOLD activity in the reward system during fMRI with the MID task, Relevant blood, CSF, and fMRI biomarkers. Genetic variants linked to dopamine, inflammation, cellular health (incl. neurodegeneration and biomarkers of brain injury), cellular stress and metabolism, growth factors and monoamine turnover (and its receptors), the blood-brain barrier and its drug transporters, and the concentration of the investigational drug. Biomarker assays will be prioritised based on scientific relevance and available funding, Accelerometery data analysing 24-hour movement behaviour, including sleep. Change in sleep patterns total sleep time (TST), wake after sleep onset (WASO), and number of awakenings (NA) between baseline and every post-baseline visit., Assessment of pramipexole levels in serum samples, Qualitative interviews with a phenomenological approach. We aim to describe the experience of treatment with pramipexole (focusing on tolerability and improvement) in patients with bipolar depression., All outcome measures will be analysed stratified by bipolar subtype in exploratory analyses

Source: https://euclinicaltrials.eu/ctis-public/view/2026-526383-20-00